EU clinical trial 2024-512633-32-00: A Phase 2, multinational, multicenter, randomized, double blind, placebo controlled, dose-ranging study to evaluate the efficacy and safety of SAR441566 in adults with moderate to severe Crohn’s disease.
Protocol code: DRI18212
Sponsor: Sanofi-Aventis Recherche & Developpement (Pharmaceutical company). Phase: Therapeutic exploratory (Phase II). Countries: Hungary (ongoing, recruitment ended), Spain (ended), France (ongoing, recruitment ended), Bulgaria (ongoing, recruitment ended), Czechia (ongoing, recruitment ended), Croatia (ended), Poland (ongoing, recruitment ended), Romania (ended), Germany (ongoing, recruitment ended), Italy (ended), Netherlands (ongoing, recruitment ended).
Therapeutic area(s): Diseases [C] - Digestive System Diseases [C06]
Gender: Female, Male. Age: 18-64 years, 65+ years. Enrolment: 193.
Start date (EU): 2025-04-07. Decision date: 2025-01-31. Results received: No. Last updated: 2026-07-02.
Decision dates by country: PL: 2025-02-05, FR: 2025-01-31, IT: 2025-02-03, NL: 2025-02-04, BG: 2025-02-03, CZ: 2025-02-05, HR: 2025-02-04, HU: 2025-02-04, RO: 2025-02-05, ES: 2025-02-03, DE: 2025-04-28

Condition(s): Crohn's disease
Product: Match placebo to test product, Balinatunfib

Primary endpoint: Proportion of participants achieving endoscopic response
Endpoint(s): Proportion of participants achieving clinical remission based on Crohn’s Disease Activity Index (CDAI), Proportion of participants achieving Patient-Reported Outcome (PRO-2) remission, Proportion of participants achieving both clinical remission and endoscopic response, Proportion of participants achieving endoscopic remission based on centrally read SES-CD, Proportion of participants achieving CDAI clinical response, Proportion of participants achieving Inflammatory Bowel Disease Questionnaire (IBDQ) remission, Proportion of participants achieving IBDQ response, Change from baseline in the IBDQ scores, Plasma pre-dose concentrations of SAR441566 at selected visits, Plasma post-dose concentrations of SAR441566 at selected visits, Number of participants experiencing any TEAEs.Any TEAEs, including any serious opportunistic infections, psoriasiform skin lesions or other immune mediated phenomena during double-blind (DB) induction and maintenance treatment period, Number of participants experiencing any TEAEs. Any TEAEs, including any serious opportunistic infections, psoriasiform skin lesions or other immune mediated phenomena during open-label treatment period

Source: https://euclinicaltrials.eu/ctis-public/view/2024-512633-32-00